EU clinical trial 2023-504986-22-00: Linezolid or vancomycin surgical site infection prophylaxis LOVip
Sponsor: Assistance Publique Hopitaux De Marseille (Hospital/Clinic/Other health care facility). Phase: Therapeutic confirmatory (Phase III). Countries: France (ongoing, recruiting).
Therapeutic area(s): Not possible to specify
Gender: Female, Male. Age: 18-64 years, 65+ years. Enrolment: 1160.
Status: Ongoing, recruiting. Start date (EU): 2024-09-30. Decision date: 2023-08-18. Results received: No. Last updated: 2025-12-12.

Condition(s): surgical antibiotic prophylaxis
Product: VANCOMYCIN, VANCOMYCINE SANDOZ 500 mg, poudre pour solution à diluer pour perfusion ou pour solution buvable, VANCOMYCINE SANDOZ 250 mg, poudre pour solution à diluer pour perfusion, Vancomycine MIP 1000 mg, poudre pour solution pour perfusion, VANCOMYCINE SANDOZ 125 mg, poudre pour solution à diluer pour perfusion, VANCOMYCINE VIATRIS 250 mg, poudre pour solution à diluer pour perfusion, Vancomycine MIP 500 mg, poudre pour solution pour perfusion, VANCOMYCINE VIATRIS 1000 mg, poudre pour solution à diluer pour perfusion, VANCOMYCINE HIKMA 500 mg, Poudre pour solution à diluer pour perfusion, Linezolid Kabi 2 mg/ml solution for infusion, VANCOMYCINE SANDOZ 1 g, poudre pour solution à diluer pour perfusion, VANCOMYCINE VIATRIS 125 mg, poudre pour solution à diluer pour perfusion, VANCOMYCINE HIKMA 1000 mg, Poudre pour solution à diluer pour perfusion, VANCOMYCINE VIATRIS 500 mg, poudre pour solution à diluer pour perfusion ou pour solution buvable

Primary endpoint: The primary objective of this study is to show the non-inferiority in terms of rate of d30 post-surgery SSIs in patients receiving linezolid 1200 mg as surgical antibiotic prophylaxis compared with patients receiving vancomycin 30 mg/kg.

Source: https://euclinicaltrials.eu/ctis-public/view/2023-504986-22-00